EU clinical trial 2024-515175-35-00: A Phase 1 Study of TAS0612 in Patients with Locally Advanced or Metastatic Solid Tumors
Protocol code: TAS0612-101
Sponsor: Taiho Oncology Inc. (Pharmaceutical company). Phase: Human Pharmacology (Phase I)- First administration to humans. Countries: Belgium (ended), Spain (ended), France (ended), Italy (ended).
Therapeutic area(s): Diseases [C] - Neoplasms [C04]
Gender: Female, Male. Age: 18-64 years, 65+ years. Enrolment: 60.
Status: Ended. Start date (EU): 2021-02-10. End date (EU): 2024-10-24. End date: 2024-11-14. Decision date: 2024-10-02. Results received: No. Last updated: 2024-10-07.
Decision dates by country: BE: 2024-10-02, FR: 2024-10-03, IT: 2024-10-07, ES: 2024-10-03

Condition(s): Locally Advanced or Metastatic Solid Tumors

Source: https://euclinicaltrials.eu/ctis-public/view/2024-515175-35-00